EU clinical trial 2024-517863-22-00: Phase III study in mCRC patients with RAS/BRAF wild type tissue and RAS/BRAF mutated in LIquid BIopsy to compare in first-line therapy FOLFIRI plus CetuxiMAb or BevacizumaB
Protocol code: LIBImAb
Sponsor: Azienda USL IRCCS Di Reggio Emilia (Hospital/Clinic/Other health care facility). Phase: Therapeutic confirmatory (Phase III). Countries: Italy (ongoing, recruiting).
Therapeutic area(s): Diseases [C] - Neoplasms [C04]
Gender: Female, Male. Age: 18-64 years, 65+ years. Enrolment: 996.
Status: Ongoing, recruiting. Start date (EU): 2024-12-01. Decision date: 2024-11-11. Results received: No. Last updated: 2026-03-02.

Condition(s): Study population consists in patients with a diagnosis of mCRC who have never received systemic treatment for advanced/metastatic disease and who are candidate to receive a first line therapy with FOLFIRI plus cetuximab or bevacizumab
Product: FLUOROURACIL, BEVACIZUMAB, IRINOTECAN, CETUXIMAB, CALCIUM LEVOFOLINATE

Primary endpoint: The primary endpoint will be PFS
Endpoint(s): Overall survival, Objective Response Rate, Prevalence of RAS/BRAF mutation, Safety, Compliance

Source: https://euclinicaltrials.eu/ctis-public/view/2024-517863-22-00